EU clinical trial 2023-506897-11-00: (21177) A randomized, double-blind, placebo-controlled, parallel-group, multicenter Phase 3 study to investigate the efficacy and safety of Finerenone, in addition to standard of care, on the progression of kidney disease in patients with Non-Diabetic Chronic Kidney Disease
Protocol code: 21177
Sponsor: Bayer AG (Pharmaceutical company). Phase: Therapeutic confirmatory (Phase III). Countries: Bulgaria (ended), Denmark (ended), Spain (ended), Czechia (ended), Hungary (ended), Italy (ended), Portugal (ended), Belgium (ended), Greece (ended).
Therapeutic area(s): Diseases [C] - Cardiovascular Diseases [C14]
Gender: Female, Male. Age: 18-64 years, 65+ years. Enrolment: 391.
Status: Ended. Start date (EU): 2021-10-18. End date (EU): 2026-02-02. End date: 2026-02-03. Decision date: 2024-04-18. Results received: No. Last updated: 2025-10-31.
Decision dates by country: BE: 2024-04-26, BG: 2024-04-18, CZ: 2024-04-19, HU: 2024-04-19, PT: 2024-04-18, IT: 2024-05-09, DK: 2024-04-18, GR: 2024-06-28, ES: 2024-04-18

Condition(s): Non-diabetic chronic kidney disease
Product: Finerenone, Placebo, Placebo, BAY 94-8862

Primary endpoint: Mean rate of change as measured by the total slope of eGFR from baseline to Month-32.
Endpoint(s): Time to the composite of kidney failure, sustained eGFR decline of >= 57%, heart failure hospitalization or Cardiovascular (CV) death, Time to the composite of kidney failure or sustained eGFR decline of >=57%, Time to the composite to heart failure hospitalization or CV death, Number of participants with Treatment-emergent adverse event (TEAE)s, Treatment-emergent serious adverse event (TESAE)s and Adverse event of special interest (AESI)

Source: https://euclinicaltrials.eu/ctis-public/view/2023-506897-11-00